EU clinical trial 2023-509621-45-00: A Phase I/II safety and efficacy study of Vibrio alginolyticus collagenase in patients with Peyronie’s Disease A Phase I single ascending dose with a Phase II expansion, safety, tolerability, efficacy, pharmacokinetics and immunogenicity study
Protocol code: RRE8_23_01
Sponsor: Fidia Farmaceutici S.p.A. (Pharmaceutical company). Phase: Phase I and Phase II (Integrated)- Other. Countries: Italy (ongoing, recruiting).
Therapeutic area(s): Diseases [C] - Male Urogenital Diseases [C12]
Gender: Male. Age: 18-64 years, 65+ years. Enrolment: 100.
Status: Ongoing, recruiting. Start date (EU): 2025-04-22. Decision date: 2025-01-31. Results received: No. Last updated: 2026-05-26.

Condition(s): Peyronie’s Disease
Product: VIBRIO ALGINOLYTICUS COLLAGENASE, ALPROSTADIL

Primary endpoint: PHASE I PART - ENDPOINTS: Overall safety and tolerability profile of each tested escalating dose of V. alginolyticus collagenase in order to identify the Maximum Tolerated Dose., PHASE II PART - ENDPOINTS: Percentage of reduction in maximal penile curvature deformity as change from baseline (screening assessment) at 29±2 days after the 3rd injection (Day 88±2) for Dose regimen A and 42±2 days after the 8th injection (Day 169±2) for Dose regimen B. Penile curvature angle will be measured using a goniometer device, after alprostadil induction of an erection.
Endpoint(s): PHASE I PART - ENDPOINTS: Percentage of responders evaluated using the Global Assessment of Peyronie’s Disease 29±2 days after the injection of V. alginolyticus collagenase into the penile plaque., PHASE I PART - ENDPOINTS: Evaluation of the change from baseline in total penile discomfort assessed 29±2 days after the injection of V. alginolyticus collagenase into the penile plaque., PHASE I PART - ENDPOINTS: Blood exposure, evaluated as serum levels of collagenase at pre-dose and at 0.5, 1, 2 and 4 h post-dose after each tested escalating dose of V. alginolyticus collagenase., PHASE I PART - ENDPOINTS: Immunogenicity, evaluated through assay of serum anti-drug antibodies (ADA) and neutralising antibodies (nAb) at pre-dose and at 29±2 days after each tested escalating dose of V. alginolyticus., PHASE II PART - ENDPOINTS: Percentage of responders based on the Global Assessment of Peyronie’s Disease assessed up to 29±2 days after the 3rd injection (Day 88±2) for Dose regimen A and up to 42±2 days after the 8th injection (last injection; Day 169±2) for Dose regimen B, of V. alginolyticus collagenase into the penile plaque., PHASE II PART - ENDPOINTS: Penile plaque consistency scores, assessed at screening, 29±2 days after each injection and at the follow-up visit month 6±15 days for Dose regimen A and 42±2 days after each treatment cycle and at the follow-up visit month 6±15 days for Dose regimen B, of V. alginolyticus collagenase into the penile plaque., PHASE II PART - ENDPOINTS: Evaluation of the change from baseline in total penile discomfort assessed 29±2 days after the 3rd injection (Day 88±2) for Dose regimen A and 42±2 days after the 8th injection (last injection; Day 169±2) for Dose regimen B of V. alginolyticus collagenase into the penile plaque., PHASE II PART - ENDPOINTS: Proportion of composite responders defined as patients with a percentage reduction from baseline (screening assessment) 29±2 days after the 3rd injection (Day 88±2) for Dose regimen A and 42±2 days after the 8th injection (Day 169±2) for Dose regimen B in maximal penile curvature of ≥20% and [(a reduction from baseline in penile discomfort of ≥1 (total score)) OR (a change from not being able to have a sexual intercourse at screening to having sexual intercourses durin, PHASE II PART - ENDPOINTS: Change from baseline (screening assessment) in: • penile length (long side length, short side length), • circumference measured at the maximum curvature point, • maximal penile curvature measured by goniometry, • penile hemodynamic parameters [Peak systolic right and left, IR (Resistance Index), Rigidity]...., PHASE II PART - ENDPOINTS: Change from baseline for the three domains (Erection, Ejaculation and Satisfaction scales) of the MSHQ, assessed 29±2 days after the 3rd injection (Day 88±2) for Dose regimen A and 42±2 days after the 8th injection (last injection; Day 169±2) for Dose regimen B, of V. alginolyticus collagenase into the penile plaque., PHASE II PART - ENDPOINTS: Overall safety and tolerability profile following each injection of V. alginolyticus collagenase [Treatment-Emergent Adverse Events; vital signs (blood pressure, pulse rate), physical examinations; laboratory tests; ECGs]., PHASE II PART - ENDPOINTS: Blood exposure, evaluated as serum levels of collagenase at pre-dose and 0.5, 1, 2 and 4 h post-dose after each injection (Days 1, 30±2 and 59±2) for Dose regimen A and after the second injection of each treatment cycle (24-72 h after the first injection of each treatment cycle) for Dose regimen B of V. alginolyticus collagenase., PHASE II PART - ENDPOINTS: Immunogenicity, evaluated through assay of serum anti-drug antibodies (ADA) and neutralising antibodies (nAb) in all subjects, at pre-dose and at 29±2 days after last injection (Day 88±2) for Dose regimen A, and at 42±2 days after both the 4th and 8th injections (Days 85±2 and 169±2) for Dose regimen B.

Source: https://euclinicaltrials.eu/ctis-public/view/2023-509621-45-00